EU clinical trial 2025-522486-29-01: Impact of Oral Semaglutide on Platelet Reactivity in Patients with Diabetes Mellitus or Overweight with High Risk or established Cardiovascular Disease: the SEMA-PLAT Study
Sponsor: Casa Di Cura Accreditata Istituto Chirurgico Ortopedico Traumatologico Marco Pasquali (Hospital/Clinic/Other health care facility). Phase: Therapeutic confirmatory (Phase III). Countries: Italy (authorised, recruitment pending).
Therapeutic area(s): Diseases [C] - Cardiovascular Diseases [C14]; Diseases [C] - Nutritional and Metabolic Diseases [C18]
Gender: Female, Male. Age: 18-64 years, 65+ years. Enrolment: 212.
Status: Authorised, recruitment pending. Decision date: 2026-04-23. Results received: No. Last updated: 2026-04-23.

Condition(s): Diabetes Mellitus, Cardiovascular disease, Overweight (BMI ≥27 kg/m²), Obesity (BMI≥30kg/m2)
Product: Wegovy 2.4 mg solution for injection in pre-filled pen, Rybelsus 14 mg tablets, Clopidogrel Medreg 75 mg filmom obalené tablety, Wegovy 0.25 mg solution for injection in pre-filled pen, Wegovy 0.5 mg solution for injection in pre-filled pen, Wegovy 1 mg solution for injection in pre-filled pen, Rybelsus 7 mg tablets, Wegovy 1.7 mg solution for injection in pre-filled pen, Acetylsalicylic acid Krka 100 mg enterotabletter, Rybelsus 3 mg tablets

Primary endpoint: Change in platelet reactivity assessed by light transmission aggregometry [LTA] following ADP (2 and 5 μmol/L) and collagen (2 μg/mL) stimuli between groups at T3;
Endpoint(s): Changes between groups at different time points (T1, T2 and T3) in: • Markers of thrombus formation (T-TAS AUC, P-selectin, aGPIIbIIIa, PDMP) • Inflammatory markers (IL-1, IL-6); • Oxidative stress markers (H₂O₂, sNOX2-dp, HBA); • Endothelial function markers (NO, endothelin-1); • Autophagy markers (p62, LC3, ATG5).

Source: https://euclinicaltrials.eu/ctis-public/view/2025-522486-29-01